EU clinical trial 2022-502965-34-00: A multicenter, single arm, open-label extension study to evaluate the long-term safety, tolerability and efficacy of iptacopan in participants with atypical hemolytic uremic syndrome (aHUS) who have completed a preceding iptacopan phase 3 study in aHUS
Protocol code: CLNP023F12001B
Sponsor: Novartis Pharma AG (Pharmaceutical company). Phase: Therapeutic confirmatory (Phase III). Countries: Czechia (ongoing, recruiting), Italy (authorised, recruitment pending), France (authorised, recruitment pending), Germany (authorised, recruitment pending), Spain (authorised, recruitment pending).
Therapeutic area(s): Diseases [C] - Immune System Diseases [C20]
Gender: Female, Male. Age: 18-64 years, 65+ years. Enrolment: 33.
Start date (EU): 2025-01-08. Decision date: 2024-10-21. Results received: No. Last updated: 2026-08-03.
Decision dates by country: CZ: 2024-10-21, IT: 2026-07-24, FR: 2026-07-23, DE: 2026-08-03, ES: 2026-06-29

Condition(s): Atypical Hemolytic Uremic Syndrome (aHUS)
Product: IPTACOPAN

Primary endpoint: Safety evaluations including adverse events (AE) /serious adverse events (SAE), safety laboratory parameters, vital signs and electrocardiograms (ECGs) through study duration.
Endpoint(s): Absence of TMA manifestation without use of anti-C5 antibody throughout the study. TMA manifestation defined by the coexistence of min. two of the three criteria at the same visit attributable to aHUS: ● thrombocytopenia (platelet count decrease of ≥ 25% compared to baseline and < LLN), ● microangiopathic hemolytic anemia (hemoglobin ≤ LLN for age and gender and LDH ≥ 1.5 x ULN), ● worsening kidney function (serum creatinine increase of >25% compared to baseline levels), Complete TMA response status without the use of anti-C5 antibody therapy through study duration. Complete TMA Response is defined as: hematological normalization in platelet count (platelet count ≥150 x 109 /L) and LDH (below ULN), and improvement in kidney function (≥ 25% serum creatinine reduction from baseline or ≥ 25% serum creatinine reduction compared to serum creatinine values prior to initiation of anti-C5 antibody therapy), Observed value and change from baseline in eGFR and CKD stage (1-5) based on eGFR categories through study duration, Dialysis requirement status through study duration, TMA related events during the study defined as any of the following: ● Irreversible (>3 months) reduction in eGFR rate by ≥20%, not attributable to another cause ● An episode of acute kidney injury (AKI) attributed to a TMA that requires renal replacement therapy ● A non-renal manifestation of a TMA that requires hospitalization or causes irreversible organ damage or death

Source: https://euclinicaltrials.eu/ctis-public/view/2022-502965-34-00